EU clinical trial 2023-510532-36-00: In vivo quantification of Hsp90 in the human brain in healthy aging and neurodegeneration using the novel PET radioligand [11C]HSP990
Protocol code: S68531
Sponsor: UZ Leuven (Hospital/Clinic/Other health care facility). Phase: Human Pharmacology (Phase I)- First administration to humans. Countries: Belgium (ongoing, recruiting).
Therapeutic area(s): Diseases [C] - Nervous System Diseases [C10]; Analytical, Diagnostic and Therapeutic Techniques and Equipment [E] - Diagnosis [E01]; Analytical, Diagnostic and Therapeutic Techniques and Equipment [E] - Investigative Techniques [E05]
Gender: Female, Male. Age: 18-64 years, 65+ years. Enrolment: 48.
Status: Ongoing, recruiting. Start date (EU): 2024-09-04. Decision date: 2024-06-13. Results received: No. Last updated: 2024-06-13.

Condition(s): Alzheimer's Disease, Amyotrophic Lateral Sclerosis, Parkinson's Disease

Source: https://euclinicaltrials.eu/ctis-public/view/2023-510532-36-00